EU clinical trial 2025-521827-61-00: Teclistamab plus autologous lymphocytes infusion for the treatment of relapsed/refractory Multiple Myeloma (TALIM). MM0125
Protocol code: MM0125
Sponsor: Fondazione Gimema Franco Mandelli Onlus (Patient organisation/association). Phase: Therapeutic exploratory (Phase II). Countries: Italy (authorised, recruitment pending).
Therapeutic area(s): Diseases [C] - Hemic and Lymphatic Diseases [C15]
Gender: Female, Male. Age: 18-64 years, 65+ years. Enrolment: 52.
Status: Authorised, recruitment pending. Decision date: 2026-04-14. Results received: No. Last updated: 2026-08-07.

Condition(s): refractory/relapsed multiple myeloma
Product: TECLISTAMAB, TECLISTAMAB

Primary endpoint: Estimation of the DoR at 18 months from the combination therapy (24 months from the beginning of Te monotherapy).
Endpoint(s): Response at cycles 5 and every 3 cycles according to the IMWG criteria (15), PFS at 18 months from beginning of therapy with Te and ALI, Overall Survival at 24 months from the beginning of therapy with Te, Safety profile overall and with a focus on CRS according to ASTCT (16) and ICANS according to ASTCT (16)

Source: https://euclinicaltrials.eu/ctis-public/view/2025-521827-61-00